EU clinical trial 2025-521912-21-00: A multi- center, randomized, double-blind, placebo-controlled parallel–group, dose-finding study to evaluate efficacy, safety, and tolerability of DII235 in adults with elevated Lipoprotein(a)
Protocol code: CDII235A12201
Sponsor: Novartis Pharma AG (Pharmaceutical company). Phase: Therapeutic exploratory (Phase II). Countries: Germany (ongoing, recruitment ended).
Therapeutic area(s): Diseases [C] - Cardiovascular Diseases [C14]; Phenomena and Processes [G] - Metabolism [G03]
Gender: Female, Male. Age: 18-64 years, 65+ years. Enrolment: 72.
Status: Ongoing, recruitment ended. Start date (EU): 2026-01-26. Decision date: 2026-01-13. Results received: No. Last updated: 2026-07-28.

Condition(s): Cardiovascular risk reduction in participants with elevated Lp(a)
Product: SODIUM CHLORIDE, DII235

Primary endpoint: Time averaged percent change from baseline in Lp(a) measured between Day 60 and Day 180, Time averaged percent change from baseline in Lp(a) measured between Day 60 and Day 360
Endpoint(s): Time averaged percent change from baseline in Lp(a) measured (i) between Day 60 and Day 360; and (ii) between Day 240 and Day 360, Participant's status of achieving Lp(a) < 125 nmol/L at Day 180 and Day 360 (Yes, No), Participant's status of achieving Lp(a) < 75 nmol/L at Day 180 and Day 360, Incidence of Adverse events, safety laboratory parameters, and vital signs

Source: https://euclinicaltrials.eu/ctis-public/view/2025-521912-21-00